EU clinical trial 2022-501201-13-00: A Phase 2a Randomized, Placebo-Controlled Clinical Study to Evaluate the Efficacy and Safety of MK-5475 in Adults With Pulmonary Hypertension Associated With Chronic Obstructive Pulmonary Disease.
Protocol code: MK-5475-013
Sponsor: Merck Sharp & Dohme LLC (Pharmaceutical company). Phase: Therapeutic exploratory (Phase II). Countries: Italy (ongoing, recruitment ended), Germany (ongoing, recruitment ended), France (ongoing, recruitment ended), Belgium (ongoing, recruitment ended), Spain (ongoing, recruitment ended), Austria (ongoing, recruitment ended).
Therapeutic area(s): Diseases [C] - Respiratory Tract Diseases [C08]
Gender: Female, Male. Age: 18-64 years, 65+ years. Enrolment: 39.
Status: Ongoing, recruitment ended. Start date (EU): 2023-03-01. Decision date: 2023-01-23. Results received: No. Last updated: 2026-07-17.
Decision dates by country: FR: 2023-01-25, DE: 2023-01-25, ES: 2023-01-25, BE: 2023-01-23, IT: 2023-01-23, AT: 2023-01-25

Condition(s): Pulmonary hypertension associated with chronic obstructive pulmonary disease (PH-COPD).
Product: MK-5475, Placebo for MK-5475

Primary endpoint: Mean change from baseline in 6-minute walk distance (6MWD) at Week 24
Endpoint(s): Mean change from baseline in 6MWD at Week 12, Mean change from baseline in N-terminal pro B-type natriuretic peptide (NT-proBNP) at Week 12, Mean change from baseline in NT-proBNP at Week 24, Percentage of participants whose World Health Organization (WHO) Functional Class does not worsen relative to baseline at Week 12, Percentage of participants whose WHO Functional Class does not worsen relative to baseline at Week 24, Percentage of participants with one or more adverse events (AEs), Percentage of participants who discontinued study treatment due to an AE

Source: https://euclinicaltrials.eu/ctis-public/view/2022-501201-13-00